EU clinical trial 2024-514143-28-00: Diagnostic treatment-trial for autonomous cortisol secretion- a tool to select patients for adrenalectomy (Metycor)
Protocol code: 2024-514143-28-00
Sponsor: Helse Bergen HF (Hospital/Clinic/Other health care facility). Phase: Therapeutic use (Phase IV). Countries: Norway (ongoing, recruiting).
Therapeutic area(s): Diseases [C] - Hormonal diseases [C19]
Gender: Female, Male. Age: 18-64 years, 65+ years. Enrolment: 100.
Status: Ongoing, recruiting. Start date (EU): 2025-08-01. Decision date: 2024-11-11. Results received: No. Last updated: 2024-11-11.

Condition(s): Mild autonomous cortisol secretion
Product: Metycor 250 mg myke kapsler

Primary endpoint: Lowering of s-Cortisol levels by half and/or below 300 nmol/l in basal morning test based on assessments before and after a trial treatment period of 6 months, Reduction in Blood pressure with a 10 % reduction in systolic and /or diastolic blood pressure via standard blood pressure measurement and/ or a 5% nocturnal dip measured via 24 h blood pressure measurement based on assessments before and after a trial treatment period of 6 months, Significant improvement in glycemic control defined as 5% (5 mmol/mol) reduction in HbA1C, or 10% increase in TIR based on assessments before and after a trial treatment period of 6 months
Endpoint(s): Weight reduction of more than 2 kg during the treatment period of 6 months is considered a significant weight reduction, There will be a categorically assessment whether there is a change in bone markers (PINP, CTX, osteoklasien) from degradation to build-up of bone, before compared to after treatment for 6 months with Metycor., A 5% decrease in LDL- cholesterol is considered significant after a treatment periode of 6 months with Metycor., Change in score of general quality of life measured as SF36, and disease-specific questionaire Cushing QoL will be assessed individually for each form, and baseline will be compared with 6 months., BMI will be measured/calculated at baseilinge, 3 months and 6 monts. The effect on BMI will be calculated between baseline and 6 months.

Source: https://euclinicaltrials.eu/ctis-public/view/2024-514143-28-00